EU clinical trial 2024-519624-24-00: "H3RAKLES": Tucatinib and trastuzumab in HER3-mutant and HER2-not amplified metastatic breast cancer
Protocol code: IC 2024-01
Sponsor: Institut Curie (Hospital/Clinic/Other health care facility). Phase: Therapeutic exploratory (Phase II). Countries: France (authorised, recruitment pending).
Therapeutic area(s): Diseases [C] - Neoplasms [C04]
Gender: Female, Male. Age: 18-64 years, 65+ years. Enrolment: 20.
Status: Authorised, recruitment pending. Decision date: 2025-09-11. Results received: No. Last updated: 2025-09-11.

Condition(s): HER3-mutant and HER2-not amplified metastatic breast cancer
Product: Ogivri 150 mg powder for concentrate for solution for infusion, TUKYSA 50 mg film-coated tablets, TUKYSA 150 mg film-coated tablets

Primary endpoint: Clinical benefit rate (CBR), defined as the proportion of patients who achieved a complete response (CR), a partial response (PR), or had stable disease (SD) for 24 weeks or more, according to the investigator-assessed RECIST v1.1 criteria.
Endpoint(s): Progression-free survival (PFS), defined as the time from inclusion to progression or death; Objective response rate, defined as the proportion of patients who achieved a CR or PR according to the investigator-assessed RECIST v1.1 criteria; and duration of response, defined as the time between the first observation of a PR or a CR, and progressive disease or death, Adverse Events (AEs) and Serious Adverse Events (SAEs), per CTCAE v5.0, considered by the investigator as related to trastuzumab or tucatinib., QLQ-C30 QoL questionnaire with the QLQ-BR42 module will be filled at inclusion, at cycles 1 and 3 and at the end of the treatment., Exploratory: relationship between biomarkers (including, but not limited to, DNA, RNA and proteins analyses) in blood, plasma, and/or tumor and either (1) presence of an ERBB3 mutation and (2) treatment efficacy.

Source: https://euclinicaltrials.eu/ctis-public/view/2024-519624-24-00